EU clinical trial 2023-503756-27-00: A Phase II, Single-Arm Study of Atezolizumab in Patients with Locally Advanced, Unresectable Stage III Non-Small Cell Lung Cancer who have not Progressed after Platinum-Based Concurrent Chemoradiation
Protocol code: MO43156
Sponsor: F. Hoffmann-La Roche AG (Pharmaceutical company). Phase: Therapeutic exploratory (Phase II). Countries: Slovenia (ended), Spain (ended).
Therapeutic area(s): Diseases [C] - Neoplasms [C04]
Gender: Female, Male. Age: 18-64 years, 65+ years. Enrolment: 13.
Status: Ended. Start date (EU): 2022-03-31. End date (EU): 2025-11-21. End date: 2025-12-03. Decision date: 2024-02-19. Results received: Yes. Last updated: 2025-10-23.
Decision dates by country: ES: 2024-02-19, SI: 2024-02-20

Condition(s): Non-Small Cell Lung Cancer (NSCLC)
Product: Tecentriq 840 mg concentrate for solution for infusion

Primary endpoint: 1. 12-month progression-free survival (PFS) rate, defined as the proportion of patients who have not experienced disease progression, as determined by an Independent Review Facility (IRF) according to Response Evaluation Criteria in Solid Tumors, Version 1.1 (RECIST v1.1), or death from any cause, at 12 months
Endpoint(s): 1. IRF-assessed PFS, defined as the time from initiation of study treatment to the first occurrence of disease progression, as determined by the IRF according to RECIST v1.1, or death from any cause, whichever occurs first, 2. Investigator-assessed PFS, defined as the time from initiation of study treatment to the first occurrence of disease progression, as determined by the Investigator according to RECIST v1.1, or death from any cause, whichever occurs first, 3. Overall survival (OS), defined as the time from initiation of study treatment to death from any cause, 4. Confirmed objective response rate (ORR), defined as the proportion of patients with a confirmed objective response (i.e., complete response [CR] or partial response [PR] on two consecutive occasions ≥ 4 weeks apart), as determined by the IRF and investigator according to RECIST v1.1, 5. Duration of response (DOR) in patients with confirmed ORR, defined as the time from the first occurrence of a documented objective response to disease progression as determined by the IRF and investigator according to RECIST v1.1 or death from any cause, whichever occurs first, 6. PFS rate at 18 months and 24 months, defined as the proportion of patients who have not experienced disease progression, as determined by the IRF and investigator according to RECIST v1.1, or death from any cause at 18 months and 24 months, respectively, 7. OS rate at 12 months, 24 months and 36 months, defined as the proportion of patients who have not died from any cause at 12 months, 24 months and 36 months, respectively, 8. Time to death or distant metastasis (TTDM), defined as the time from initiation of study treatment until the first date of distant metastasis or death in the absence of distant metastasis, 9. Incidence and severity of adverse events, with severity determined according to the National Cancer Institute Common Terminology Criteria for Adverse Events, Version 5.0 (NCI CTCAE v5.0)

Source: https://euclinicaltrials.eu/ctis-public/view/2023-503756-27-00